EU clinical trial 2024-511083-90-00: A Randomized, Placebo-Controlled, Double-Blind, Multicenter, Phase 2 Study to Assess the Efficacy and Safety of Daily OM-85 Treatment vs. Placebo given in Children Aged 6 Months to 5 Years with Recurrent Wheezing
Protocol code: BV-2020/09
Sponsor: OM Pharma SA (Pharmaceutical company). Phase: Therapeutic exploratory (Phase II). Countries: Hungary (ongoing, recruitment ended), Poland (ongoing, recruitment ended).
Therapeutic area(s): Diseases [C] - Respiratory Tract Diseases [C08]
Gender: Female, Male. Age: 0-17 years. Enrolment: 126.
Status: Ongoing, recruitment ended. Start date (EU): 2024-10-03. Decision date: 2024-07-16. Results received: No. Last updated: 2026-07-09.
Decision dates by country: PL: 2024-07-22, HU: 2024-07-16

Condition(s): Recurrent wheezing
Product: BRONCHO-VAXOM, 3,5mg, kapsułki, BRONCHO-VAXOM Children Capsules placebo

Primary endpoint: Rate of wheezing/asthma-like episodes (WEs) during the 6 months of the Treatment period, defined as the number of WEs experienced by a subject during the 6month Treatment period.
Endpoint(s): Rate of severe WEs during the 6month Treatment period., Rate of WE requiring OCS treatment during the 6-month Treatment period., Number of days with wheezing/asthma-like symptoms during the 6month Treatment period., Safety, including AEs, SAEs, vital signs, and physical examination.

Source: https://euclinicaltrials.eu/ctis-public/view/2024-511083-90-00